EU clinical trial 2024-517102-29-00: A Multi-center, Double-Blind, Randomized, Two-Arm, Parallel-Group, Placebo Controlled Study to Assess the Safety of ELGN-2112 in Populations of Interest
Protocol code: FIT-05
Sponsor: Elgan Pharma Ltd. (Pharmaceutical company). Phase: Therapeutic confirmatory (Phase III). Countries: Netherlands (authorised, recruitment pending), Spain (ongoing, recruiting), Austria (authorised, recruitment pending), France (ongoing, recruiting), Italy (ongoing, recruiting), Sweden (authorised, recruitment pending).
Therapeutic area(s): Diseases [C] - Congenital, Hereditary, and Neonatal Diseases and Abnormalities [C16]
Gender: Female, Male. Age: 0-17 years. Enrolment: 54.
Start date (EU): 2025-11-19. Decision date: 2024-10-30. Results received: No. Last updated: 2026-07-29.
Decision dates by country: FR: 2024-10-31, IT: 2025-10-22, NL: 2024-10-30, AT: 2024-11-05, ES: 2024-11-08, SE: 2026-04-09

Condition(s): Intestinal Malabsorption
Product: Powder for reconstitution for enteral administration

Primary endpoint: • Adverse Events (AEs) and Adverse Drug Reactions (ADRs) • Blood glucose • Blood Chemistry and haematology • Vital signs
Endpoint(s): The number of days to achieve full enteral feeding, defined as the number of days from treatment initiation to achieve enteral feeding* of at least 150 ml/kg/day for three consecutive days during the treatment period. *Defined as first day of reaching three consecutive days of EN feeds ≥150 ml/kg/day., The number of days from treatment initiation to PN wean-off during the treatment period., Incidence of severe NEC (modified Bell’s stage ≥2a) by 40 weeks post-menstrual age (PMA) or discharge home, whichever is earlier, according to modified Bell’s staging as assessed by central blinded reviewers and classified according to the “Modified Bell’s Staging Criteria for NEC” (Walsh-1986)., Distribution of severity of NEC by 40 weeks PMA or discharge home, whichever is earlier, according to modified Bell’s staging as assessed by central blinded reviewers and classified according to the “Modified Bell’s Staging Criteria for NEC” (Walsh MC 1986)., The number of days from treatment initiation to the first day the infant achieves EN volume of 120 ml/kg/day for three consecutive days during the treatment period., Percentage of infants reaching FEF for three consecutive days within 9, 12, and 16 days from treatment initiation., Percentage of infants weaned off PN within 7, 10, and 14 days from initiation of treatment., Percentage of EN and PN over total nutrition during the treatment period., Incidence of late onset sepsis (onset ≥72 hours after birth) by 40 weeks PMA or discharge home, whichever is earlier. Will be defined* as either: a) culture proven late onset sepsis OR b) clinically suspected culture negative late onset sepsis * According to EMA Report EMA/477725/2010 on the Expert Meeting on Neonatal and Paediatric Sepsis (8 June 2010), Neonatal anthropometrics measurements during the treatment period and up to 3 months CA., Incidence of at least one of the adverse events of relevance by 40 weeks PMA or discharge home, whichever is earlier: • severe NEC (modified Bell’s stage ≥2a); • late onset sepsis; death, The number of days from treatment initiation to discharge to home., Incidence and severity of ROP up to 3 months CA according to the International Classification of Retinopathy of Prematurity (ICROP3), The number of days from treatment initiation to discharge from primary hospital.

Source: https://euclinicaltrials.eu/ctis-public/view/2024-517102-29-00